EU clinical trial 2024-512001-39-01: The Norwegian Antibiotics for Pneumonia in Children (NAPIC) Study
Protocol code: NAPIC
Sponsor: Oslo University Hospital HF (Hospital/Clinic/Other health care facility). Phase: Therapeutic use (Phase IV). Countries: Norway (ongoing, recruiting).
Therapeutic area(s): Diseases [C] - Bacterial Infections and Mycoses [C01]; Diseases [C] - Respiratory Tract Diseases [C08]
Gender: Female, Male. Age: 0-17 years. Enrolment: 500.
Status: Ongoing, recruiting. Start date (EU): 2018-02-01. Decision date: 2024-12-10. Results received: No. Last updated: 2024-12-10.

Condition(s): Lower respiratory tract infection
Product: INFECTOMOX® 500 Saft 500 mg/5 ml Pulver zur Herstellung einer Suspension zum Einnehmen, Placebo for IMP including Amylum solani; Sugar; Titandioksyd; Silica colloid.anhydr. Sodium citrate; Acid. citric; Mg-stearas; Strawberry aroma; Raspberry aroma; Xantan gum; Gentiana lutea

Primary endpoint: Determined by 21 days after treatment start as: Therapy failure
Endpoint(s): Therapy failure leading to intravenous antibiotic therapy, Duration of fever, Duration of symptoms, assessed by parent/guardian, Bacterial presence in airways, Presence of resistant bacteria, Resistance genes (bacteria)

Source: https://euclinicaltrials.eu/ctis-public/view/2024-512001-39-01